EU clinical trial 2025-524456-58-00: A study on the safety of and immune response to different doses of RSV/hMPV combination and hMPV vaccines in adults
Protocol code: 223960
Sponsor: GlaxoSmithKline Biologicals (Pharmaceutical company). Phase: Phase I and Phase II (Integrated)- First administration to humans. Countries: Belgium (authorised, recruitment pending).
Therapeutic area(s): Diseases [C] - Respiratory Tract Diseases [C08]
Gender: Female, Male. Age: 18-64 years, 65+ years. Enrolment: 464.
Status: Authorised, recruitment pending. Decision date: 2026-06-04. Results received: No. Last updated: 2026-06-04.

Condition(s): Respiratory Syncytial Virus Infections+Metapneumovirus

Source: https://euclinicaltrials.eu/ctis-public/view/2025-524456-58-00